EU clinical trial 2024-515131-30-00: An Open-label, Single Agent, Phase I/II Trial Investigating the Safety and Efficacy of RVU120 (SEL120) in Patients with Relapsed / Refractory Metastatic or Advanced Solid Tumors
Protocol code: RVU120-SOL-021
Sponsor: Ryvu Therapeutics S.A. (Pharmaceutical company). Phase: Therapeutic exploratory (Phase II). Countries: Spain (ended), Poland (ended).
Therapeutic area(s): Diseases [C] - Neoplasms [C04]
Gender: Female, Male. Age: 18-64 years, 65+ years. Enrolment: 54.
Status: Ended. Start date (EU): 2023-12-18. End date (EU): 2025-10-02. Decision date: 2024-07-18. Results received: No. Last updated: 2024-08-12.
Decision dates by country: ES: 2024-07-18, PL: 2024-07-22

Condition(s): Relapsed / Refractory Metastatic or Advanced Solid Tumors
Product: SEL120 monohydrochloride, SEL120 monohydrochloride

Primary endpoint: Part 1 (Phase I), dose escalation cohorts/Part 2 Group E: • Frequency and nature of AEs, SAEs and DLTs. • Determination of the RP2D., Part 2 (Phase II): safety expansion and efficacy groups: • Frequency and nature of AEs and SAEs. The following will be assessed locally by RECIST v1.1, where applicable: • ORR • DoR • PFS • OS • CBR • CPR, when applicable
Endpoint(s): Part 1 (Phase I), dose escalation cohorts/Part 2 Group E The following will be assessed locally by RECIST v1.1, where applicable: • ORR • DoR • PFS • OS • CBR • CPR, when applicable PK variables including: • Cmax, Cmin, Tmax, t1/2, AUCtau, Part 2 (Phase II): safety expansion and efficacy groups •Using population PK modelling and subgroup analysis, PK variables including, as possible, Cmax, Cmin, Tmax, t1/2, and AUCtau

Source: https://euclinicaltrials.eu/ctis-public/view/2024-515131-30-00